EU clinical trial 2024-516125-31-02: (ACTME) Adoptive TIL therapy with low-dose PEG-IFNa plus nivolumab in metastatic melanoma
Sponsor: Leids Universitair Medisch Centrum (LUMC) (Hospital/Clinic/Other health care facility). Phase: Phase I and Phase II (Integrated)- Other. Countries: Netherlands (ongoing, recruiting).
Therapeutic area(s): Diseases [C] - Neoplasms [C04]; Diseases [C] - Skin and Connective Tissue Diseases [C17]
Gender: Female, Male. Age: 18-64 years, 65+ years. Enrolment: 58.
Status: Ongoing, recruiting. Start date (EU): 2024-12-18. Decision date: 2024-12-17. Results received: No. Last updated: 2025-08-12.

Condition(s): Metastatic Melanoma
Product: PEGINTERFERON ALFA-2A, TIL cells, Zirconium Zr 89 crefmirlimab berdoxam

Primary endpoint: Evaluation of the safety and toxicity of TIL and nivolumab, followed by the evaluation of the safety and toxicity of PEG-IFNa, nivolumab and TIL, according to CTCAE 4.0 criteria. Given the nature and severity of the disease, toxicity grade 3 or less and SAE related to treatment, but that do not result in treatment termination, are considered acceptable for continuation of the study.
Endpoint(s): Secondary endpoints include the evaluation of the disease control rate assessed by physical examination and imaging studies (CTand/or MRI) and will be evaluated according to RECIST 1.1 and immune related response criteria (irRC). Furthermore, overallsurvival (OS) and progression-free survival (PFS) will be evaluated and immune related parameters will be analysed. Quality of lifeis already measured by the DMTR and will be assessed.

Source: https://euclinicaltrials.eu/ctis-public/view/2024-516125-31-02